EU clinical trial 2024-519721-37-00: A Phase 1/2 First-Time-in-Human, open-label, multicenter, dose escalation and expansion study of the oral DNA Helicase Werner Inhibitor (WRNi) GSK4418959 alone or in combination with other anti-cancer agents in adult participants with Mismatch Repair-deficient (dMMR) or Microsatellite Instability-High (MSI-H) solid tumors (SYLVER)
Protocol code: 221971
Sponsor: Glaxosmithkline Research & Development Limited (Pharmaceutical company). Phase: Phase I and Phase II (Integrated)- First administration to humans. Countries: Netherlands (ongoing, recruitment ended), Spain (ended), Belgium (ended).
Therapeutic area(s): Diseases [C] - Neoplasms [C04]
Gender: Female, Male. Age: 18-64 years, 65+ years. Enrolment: 34.
Start date (EU): 2025-08-06. Decision date: 2025-07-14. Results received: No. Last updated: 2026-07-06.
Decision dates by country: BE: 2025-07-22, ES: 2025-07-16, NL: 2025-07-14

Condition(s): Neoplasms, Colorectal
Product: JEMPERLI 500 mg concentrate for solution for infusion

Primary endpoint: "Part 1: Incidence of participants with DLTs per dose level in the DLT observation periods. ", "Part 1: Incidence of treatment-emergent adverse events (TEAEs) per dose level in the DLT observation periods. ", Part 1: Incidence of dosage interruptions, dose reductions, and drug discontinuations for TEAEs, per dose level in the DLT observation periods., Part 2: Overall response rate, defined as percentage of participants with confirmed complete response (CR) or partial response (PR) per RECIST 1.1 by investigator assessment., "Part 3: Incidence of participants with DLTs per dose level in the DLT observation periods. ", "Part 3: Incidence of TEAEs per dose level in the DLT observation periods. ", Part 3: Incidence of dosage interruptions, dose reductions, and drug discontinuations for TEAEs, per dose level in the DLT observation periods.
Endpoint(s): "Part 1: PK parameters, as available, for GSK4418959 (Key parameters such as AUC, Cmax, Tmax). ", "Part 1: Overall incidence of TEAEs per dose level. ", "Part 1: Overall incidence of dosage interruptions, reductions, and drug discontinuations for TEAEs, per dose level. ", Part 1: Laboratory abnormalities for key parameters as characterized by type, frequency, severity, and timing., "Part 2: Incidence of TEAEs in Part 2. ", "Part 2: Overall incidence of dosage interruptions, dose reductions, and drug discontinuations for TEAEs, per dose level. ", "Part 2: Laboratory abnormalities for key parameters. ", "Part 2: Progression-free survival, defined as time from first dose to progressive disease or death from any cause, whichever is earlier. ", Part 2: Duration of Response, defined as time from first documented PR or CR to progressive disease or death from any cause, whichever is earlier for participants who have achieved a confirmed CR or PR., Part 2: Plasma PK concentrations, as available, for GSK4418959., "Part 3: PK parameters, as available, for GSK4418959 (Key parameters such as AUC, Cmax, Tmax). ", "Part 3: Overall incidence of TEAEs per dose level. ", "Part 3: Overall incidence of dosage interruptions, reductions, and drug discontinuations for TEAEs, per dose level. ", Part 3: Laboratory abnormalities for key parameters as characterized by type, frequency, severity, and timing.

Source: https://euclinicaltrials.eu/ctis-public/view/2024-519721-37-00